EU clinical trial 2025-524741-28-00: BIOlogical treatment GRAdual Interval Longing in severe Asthma (BIO-GRAIL)
Sponsor: Amsterdam UMC Stichting (Patient organisation/association). Phase: Therapeutic use (Phase IV). Countries: Netherlands (authorised, recruitment pending).
Therapeutic area(s): Diseases [C] - Respiratory Tract Diseases [C08]
Gender: Female, Male. Age: 18-64 years, 65+ years. Enrolment: 142.
Status: Authorised, recruitment pending. Decision date: 2026-06-05. Results received: No. Last updated: 2026-06-05.

Condition(s): Severe Asthma
Product: Nucala 100 mg solution for injection in pre-filled pen, CINQAERO 10 mg/mL concentrate for solution for infusion, Dupixent 200 mg solution for injection in pre-filled pen, Fasenra 30 mg solution for injection in pre-filled pen, Dupixent 300 mg solution for injection in pre-filled pen, Tezspire 210 mg solution for injection in pre-filled pen

Primary endpoint: Maintained asthma control after ~1 year of study participation with at least one step of interval prolongation. Asthma control is defined as not more than one additional exacerbation compared to baseline frequency during ~1 year and a ACQ < 2.0 at the last study visit. An exacerbation is defined as an acute worsening of symptoms lasting more than 48 hours, as assessed by the treating physician.
Endpoint(s): Exacerbation frequency per year., Blood eosinophile count in *10^9 cells per liter, FeNO in parts per billion (ppb), Forced Expiratory Volume in 1 second (FEV1), Forced Vital Capacity (FVC), FEV1/FVC, Asthma Control Questionnaire (ACQ), Severe Asthma Questionnaire (SAQ), Sino-Nasal Outcome Test (SNOT-22), Strict asthma control after algorithm guided interval prolongation for ~1 year. Strict asthma control is defined as ΔACQ < 0.5 and control of biomarkers., Detection of respiratory viruses during asthma exacerbations by PCR on nasopharyngeal swab, Blood eosinophile count in *10^9 cells per liter during asthma exacerbations, FeNO in parts per billion (ppb) during asthma exacerbations, ACQ during asthma exacerbations, SAQ during asthma exacerbations, Dosage of Inhaled Corticosteroids (ICS), Inhaler technique, 5 – item Medication Adherence Report Scale (MARS-5)

Source: https://euclinicaltrials.eu/ctis-public/view/2025-524741-28-00